EU clinical trial 2024-513593-22-00: BONG: Reducing severe Breathlessness with Dronabinol in the severe and very severe chronic obstructive pulmonary disease patient group
Sponsor: Lillebaelt Hospital (Hospital/Clinic/Other health care facility). Phase: Phase II and Phase III (Integrated). Countries: Denmark (ongoing, recruitment ended).
Therapeutic area(s): Diseases [C] - Respiratory Tract Diseases [C08]
Gender: Female, Male. Age: 18-64 years, 65+ years. Enrolment: 30.
Status: Ongoing, recruitment ended. Start date (EU): 2025-01-31. Decision date: 2024-05-14. Results received: No. Last updated: 2025-06-20.

Condition(s): Chronic obstructive pulmonary disease
Product: Dronabinol, PLACEBO

Primary endpoint: Comparison of Numeric Rating Scale (NRS) score of discomfort of daily breathlessness and daily interference of daily activities in relation to active treatment vs. placebo., Comparison of NRS score of discomfort of daily breathlessness and daily interference of daily activities in relation to amount of THC level from the blood sample of the active treatment.
Endpoint(s): Difference in MDP (multidimensional dyspnea profile) in relation to active treatment vs. placebo, Difference in CAT (COPD assessment test) in relation to active treatment vs. placebo, Difference in CRQ (chronic respiratory disease questionnaire) in relation to active treatment vs. placebo, Difference in HADS (Hospital Anxiety and Depression Scale) in relation to active treatment vs. placebo, Difference in MRC score (Medical Research Council) in relation to active treatment vs. placebo, Difference in ESS (Epworth sleepiness score) in relation to active treatment vs. placebo, Difference in Spirometry (FEV1, FVC, FEV1/FVC (ratio)) in relation to active treatment vs. placebo, Difference in 6MWT (Six-minute walk test including BORG score) in relation to active treatment vs. placebo, Difference in hair cortisol level in relation to active treatment vs. placebo, Difference in parameters from Empatica Embrace watch (such as continuous measurement of SpO2 (blood oxygen saturation), EDA (electrodermal activity), P (pulse rate), sleep recording, temperature and respiratory rate, activity counter) in relation to active treatment vs. placebo

Source: https://euclinicaltrials.eu/ctis-public/view/2024-513593-22-00